EU clinical trial 2025-521304-21-00: A single-arm, open-label, phase I/II clinical trial of autologous hematopoietic stem and progenitor cells (HSPCs) genetically modified with a lentiviral vector (LVV) encoding for the human programmed death-ligand 1 (hPD-L1) complementary deoxyribonucleic acid (cDNA) for the treatment of patients with type 1 diabetes (T1D) at recent onset and with residual β-cell function (Immunostem)
Protocol code: Immunostem
Sponsor: Altheia Science S.r.l. (Pharmaceutical company). Phase: Phase I and Phase II (Integrated)- First administration to humans. Countries: Italy (ongoing, recruiting).
Therapeutic area(s): Diseases [C] - Nutritional and Metabolic Diseases [C18]
Gender: Female, Male. Age: 18-64 years. Enrolment: 15.
Status: Ongoing, recruiting. Start date (EU): 2026-03-13. Decision date: 2025-09-30. Results received: No. Last updated: 2026-07-28.

Condition(s): Type 1 diabetes
Product: Autologous CD34+ HSPCs transduced ex vivo with a LVV encoding the hPD-L1 cDNA

Primary endpoint: Primary endpoint will be the evaluation of safety of the study treatment, including number and description of adverse events at endpoint based on vital signs, laboratory tests, frequency and severity of AEs and serious AEs. Safety parameters will be assessed over the first 3, 12 and 24 months of follow up in the patients enrolled during the pilot phase. In case of positive evaluation of safety results of the pilot phase at the 3 month assessment by the DSMB, the study will continue with the enro
Endpoint(s): Changes over time of the 3-hour area under curve (AUC) and ΔAUC normalised by baseline glucose blood levels of C-peptide response to a mixed meal tolerance test (MMTT) over 12 and 24 months., Changes of glucose metrics from continuous glucose monitoring over 12 and 24 months, including: -Time in glycaemic target range expressed as a daily average of the percentage of time in a 24 hour-day a participant's blood glucose is >70 but ≤180 mg/dL (>3.9 to ≤10.0 mmol/L) during the previous 14 days -Time in tight range (70-140 mg/dL) during the previous 14 days -Time above range (180-250 and >250 mg/dL) during the previous 14 days -Time below range (level 1: 54-70 and level 2: <54 mg/dL)., Exogenous insulin requirement defined as a daily average in units per kilogram per day (U/kg/day) during the previous 14 days., Changes and trend analysis of HbA1c levels over 12 and 24 months., Number of self-reported episodes of severe (CTCAE version 5.0 grade 3) hypoglycaemia., Longitudinal analysis of vector copy number (VCN) in peripheral blood samples to assess frequency and persistence of infused cells and their progenies., In case of VCN>the limit of quantification, execution of vector insertion site analysis (VISA)., Exploratory endpoints: Estimated Glucose Disposal Rate (eGDR); Changes in autoantibody titres (including but not limited to): Anti-insulin (anti-IAA), Anti-glutamic acid decarboxylase 65 (anti-GAD65), Anti-islet antigen 2 (anti-IA-2A), Anti-Zinc transporter 8 (anti-ZnT8), Anti-islet cell antibody (anti-ICA); Correlation between VCN and CGM-derived glucose; Changes in extended immunophenotype analyses including NK, B and T cells, T cell subpopulations, T regulatory cells (including FOXP3+ cells).

Source: https://euclinicaltrials.eu/ctis-public/view/2025-521304-21-00